EU clinical trial 2024-518741-21-00: PRODIGE 34 - ADAGE: Randomised phase III study evaluating adjuvant chemotherapy after resection of stage III colon adenocarcinoma in patients aged 70 and older
Protocol code: PRODIGE 34 - ADAGE
Sponsor: Fondation Franc.Cancerologie Digestive (Hospital/Clinic/Other health care facility). Phase: Therapeutic exploratory (Phase II). Countries: Belgium (ongoing, recruitment ended), France (ongoing, recruitment ended).
Therapeutic area(s): Diseases [C] - Digestive System Diseases [C06]
Gender: Female, Male. Age: 65+ years. Enrolment: 973.
Status: Ongoing, recruitment ended. Start date (EU): 2014-12-23. Decision date: 2025-01-17. Results received: No. Last updated: 2026-04-20.
Decision dates by country: BE: 2025-01-17, FR: 2025-01-20

Condition(s): colon cancer
Product: Xeloda 150 mg film-coated tablets, ELOXATINE 5 mg/ml, solution à diluer pour perfusion, Folinic acid (as calcium folinate) 10 mg/ml solution for injection/infusion, ELVORINE 100 mg/10 mL, solution injectable, FLUOROURACILE TEVA 1000 mg/20 ml, solution à diluer pour perfusion

Primary endpoint: The primary endpoint is relapse-free survival (RFS). It is defined as the time limit between the randomisation date and the date of the first recurrence (local or remote) or the date of death, regardless of the cause. All second cancers, colon or not, shall not be taken into account. The living patients without recurrence shall be censored at the date of their last assessment.
Endpoint(s): The dose intensity, The overall tolerance to the treatments, The time to recurrence, Overall survival, The time to decrease in autonomy, The time to decrease in the quality of life

Source: https://euclinicaltrials.eu/ctis-public/view/2024-518741-21-00